EU clinical trial 2023-503340-13-00: A multicenter, double-blinded, randomized, placebo-controlled trial to compare the effectiveness of intratympanic injections methylPREDnisolone versus placebo in the treatment of vertigo attacks in MENière’s disease (PREDMEN trial).
Protocol code: PREDMEN
Sponsor: Leiden University Medical Center (Hospital/Clinic/Other health care facility). Phase: Therapeutic confirmatory (Phase III). Countries: Netherlands (ongoing, recruiting).
Therapeutic area(s): Diseases [C] - Otorhinolaryngologic Diseases [C09]
Gender: Female, Male. Age: 18-64 years, 65+ years. Enrolment: 148.
Status: Ongoing, recruiting. Start date (EU): 2023-10-05. Decision date: 2023-05-23. Results received: No. Last updated: 2026-06-22.

Condition(s): Menière's disease
Product: Gentamicine CF 40 mg/ml, injectievloeistof, Solu-Medrol 62,5 mg/ml, poeder en oplosmiddel voor oplossing voor injectie, Natriumchloride 0,9 %, oplossing voor injectie, Dexamethason CF 20 mg/ml, injectievloeistof, PRIMPERAN 10 mg, suppositoire sécable, Kenacort-A 40, suspensie voor injectie 40 mg/ml

Primary endpoint: Complete or substantial control of vertigo (Class A or B).
Endpoint(s): Frequency of intratympanic injections with either gentamicin or corticosteroid (methylprednisolone, dexamethasone, triamcinolone), Pure tone audiometry, Quality of life determined by the EQ-5D-5L questionnaire (EQ-5D and EQ-VAS scores), Dizziness related quality of life as determined by the DHI and FLS questionnaires, Tinnitus related quality of life as determined by the TFI questionnaires, (Serious) Adverse events, SUSARs, Cost effectiveness and cost-utility, Frequency of use of metoclopramide

Source: https://euclinicaltrials.eu/ctis-public/view/2023-503340-13-00